EU clinical trial 2023-507498-16-00: A Phase I/II Trial of Mosunetuzumab (BTCT4465A) as Consolidation Therapy in Patients with Diffuse Large B-Cell Lymphoma following First-Line Immunochemotherapy and as Monotherapy or In Combination With Polatuzumab Vedotin in Elderly/Unfit Patients with Previously Untreated Diffuse Large B-Cell Lymphoma
Protocol code: GO40554
Sponsor: F. Hoffmann-La Roche AG (Pharmaceutical company). Phase: Phase I and Phase II (Integrated)- Other. Countries: Spain (ended), Poland (ended).
Therapeutic area(s): Diseases [C] - Neoplasms [C04]
Gender: Female, Male. Age: 18-64 years, 65+ years. Enrolment: 39.
Status: Ended. Start date (EU): 2019-07-02. End date (EU): 2025-08-06. End date: 2025-08-07. Decision date: 2024-04-01. Results received: Yes. Last updated: 2025-07-14.
Decision dates by country: PL: 2024-04-19, ES: 2024-04-01

Condition(s): Diffuse Large B-Cell Lymphoma (DLBCL)
Product: Polivy 30 mg powder for concentrate for solution for infusion., Mosunetuzumab, Mosunetuzumab, RoActemra 20 mg/mL concentrate for solution for infusion, Mosunetuzumab, Mosunetuzumab, Polivy 140 mg powder for concentrate for solution for infusion., Mosunetuzumab, Mosunetuzumab

Primary endpoint: 1. Positron emission tomography–computed tomography (PET-CT) complete response (CR) rate or overall response rate (ORR) according to the Lugano 2014 criteria at primary response assessment (PRA) per investigator (INV) for Cohort A and B respectively, and PET-CT ORR at PRA by the IRC for Cohort C, 2. Incidence and severity of adverse events
Endpoint(s): 1. PET-CT CR per INV for Cohort B and C and per IRC (Cohort C only), 2. Objective response rate (ORR) at PRA per INV Cohort A and C, 3. Best ORR per INV in all Cohorts and by IRC in Cohort C, 4. Duration of response per INV in all Cohorts and by IRC in Cohort C, 5. DOCR, as determined by the investigator in all Cohorts and by the IRC (Cohort C only), 6. Progression-free survival per INV in all Cohorts and by IRC in Cohort C, 7. Overall survival, 8. Time to deterioration in EORTC QLQ-C30 physical functioning and fatigue, in EORTC IL17 physical functioning, and in the FACT-Lym subscale in Cohorts B and C, 9. Proportion of patients achieving a clinically meaningful improvement in physical functioning as measured by EORTC QLQ-C30 and EORTC IL17 (in Cohorts B and C), 10. Incidence of Antidrug antibody (ADA) to mosunetuzumab, and polatuzumab vedotin, 11. Relationship between ADAs and PK, safety, efficacy, and biomarkers may be explored as appropriate, 12. Maximum serum concentration (Cmax) and minimum serum concentration (Cmin) of mosunetuzumab (IV/SC) and polatuzumab vedotin, 13. Total exposure (area under the concentration-time curve [AUC]) of mosunetuzumab (IV/SC) and polatuzumab vedotin, 14. Time to maximum concentration (Tmax) of mosunetuzumab SC

Source: https://euclinicaltrials.eu/ctis-public/view/2023-507498-16-00